EU clinical trial 2023-503751-97-00: A Masked, Multicentre, Placebo-controlled, Randomized Phase IIa Clinical Trial to investigate the safety and efficacy of ApTOLL in a population of ST Elevation Myocardial Infarct (STEMI) patients.
Protocol code: ApSTEMI
Sponsor: Aptatargets S.L. (Pharmaceutical company). Phase: Therapeutic exploratory (Phase II). Countries: Spain (not authorised).
Therapeutic area(s): Diseases [C] - Cardiovascular Diseases [C14]
Gender: Female, Male. Age: 18-64 years, 65+ years. Enrolment: 120.
Status: Not authorised. Decision date: 2023-09-06. Results received: No. Last updated: 2023-09-06.

Condition(s): STEMI (ST Elevation Myocardial Infarct)
Product: APTOLL PLACEBO, ApTOLL

Primary endpoint: To evaluate the safety of ApTOLL in the STEMI defined population as determined by: 1. All cause death during 90 days after administration of ApTOLL 2. Incidence adverse events (AEs) during the first 72 hours after administration of treatment or until discharge (if earlier). The AEs of particular interest to this study are severe hypotension (requiring vasoactive agents), sustained ventricular arrhythmias and cardiogenic shock.
Endpoint(s): The biological effect of ApTOLL on the early infarct volume will be measured by LGE-MRI at 5 days (±48 hours) after randomization and late changes in infarct volume at 90 (±14) days after randomization. MRI parameters to be obtained will be infarct mass, infarct size (in terms of percentage of total left ventricle mass) and left ventricular ejection fraction (LVEF). MRI will be performed by local radiologists and read by a central reader upon transfer from the site radiologist., The biological effect of ApTOLL on cardiac parameters will be determined by echocardiography at 72 (±24h) and 90 (±14) days after randomization and measuring LV end-diastolic volume (LVEDV), LVEF, E-e’ ratio, trans-mitral pattern (normal, type 1, 2,3), estimated pulmonary artery pressure, inferior vena cava diameter and presence/absence of intracavitary thrombi., The biological effect of ApTOLL on pro-inflammatory biomarkers will be measured by analysing the levels of IL-6, IL-1b, IL-4, IL-10, CXCL-10, serum amyloid A (SAA), Toll-like receptor 4 (TLR4), cardiac troponin T and high-sensitivity C-reactive protein (hsCRP) at baseline, 24h, 48h and 72h after randomization.

Source: https://euclinicaltrials.eu/ctis-public/view/2023-503751-97-00